EU clinical trial 2025-523711-11-00: A Phase 3 Multicenter, Randomized, Double-blind, Placebo-controlled Study to Evaluate the Efficacy and Safety of KarXT for the Treatment of Schizophrenia in Adolescents (13 to 17 years of age)
Protocol code: CN0120020
Sponsor: Bristol-Myers Squibb Services Unlimited Company (Pharmaceutical company). Phase: Therapeutic confirmatory (Phase III). Countries: Romania (ongoing, recruiting).
Therapeutic area(s): Psychiatry and Psychology [F] - Mental Disorders [F03]
Gender: Female, Male. Age: 0-17 years. Enrolment: 28.
Status: Ongoing, recruiting. Start date (EU): 2026-06-29. Decision date: 2026-04-20. Results received: No. Last updated: 2026-04-20.

Condition(s): Schizophrenia
Product: KarXT, KarXT Matching Placebo, KarXT, KarXT

Primary endpoint: Change from baseline in Positive and Negative Syndrome Scale (PANSS) total score at Week 5
Endpoint(s): Change from baseline in Clinical Global Impression -Severity (CGI-S) score at Week 5

Source: https://euclinicaltrials.eu/ctis-public/view/2025-523711-11-00